EU clinical trial 2023-506019-16-03: CELL-BASED IMMUNOTHERAPY FOR TREATMENT OF TRIPLE NEGATIVE BREAST CANCER STAGES II AND III
Protocol code: aHyC-TNBC
Sponsor: Celica d.o.o. (Laboratory/Research/Testing facility). Phase: Phase I and Phase II (Integrated)- First administration to humans. Countries: Slovenia (authorised, recruitment pending).
Therapeutic area(s): Diseases [C] - Neoplasms [C04]
Gender: Female, Male. Age: 18-64 years, 65+ years. Enrolment: 82.
Status: Authorised, recruitment pending. Decision date: 2026-03-31. Results received: No. Last updated: 2026-03-31.

Condition(s): TRIPLE NEGATIVE BREAST CANCER

Source: https://euclinicaltrials.eu/ctis-public/view/2023-506019-16-03